EU clinical trial 2024-518819-19-00: Phase II Study of daTopotamab-derUXtecan (Dato-DXd; DS-1026a) in triple-negative brEast cancer patients with newly Diagnosed or prOgressing brain metastases
Protocol code: Tuxedo-2
Sponsor: Medical University Of Vienna (Educational Institution). Phase: Therapeutic exploratory (Phase II). Countries: Austria (authorised, recruiting), Ireland (authorised, recruitment pending).
Therapeutic area(s): Diseases [C] - Neoplasms [C04]
Gender: Female, Male. Age: 18-64 years, 65+ years. Enrolment: 26.
Start date (EU): 2023-05-23. Decision date: 2024-12-10. Results received: No. Last updated: 2026-01-23.
Decision dates by country: IE: 2026-01-23, AT: 2024-12-10

Condition(s): triple negative breast cancer
Product: Datopotamab deruxtecan

Primary endpoint: intracranial response rate at any timepoint as judged by best response during the study period (response measured according to RANO-BM criteria)
Endpoint(s): extracranial response rate (response measured according to RECIST 1.1), bicompartmental clinical benefit rate (CBR; CR+PR+SD ≥6 months; intracranial CBR measured by RANO-BM; extracranial CBR measured by RECIST 1.1), progression-free survival, overall survival

Source: https://euclinicaltrials.eu/ctis-public/view/2024-518819-19-00